EU clinical trial 2024-515557-22-00: A randomized, two-armed, single-blind, parallel, active controlled, and non-inferiority clinical trial to Compare Efficacy and Safety of anti TNF-alfa biosimilar molecules to the originators in children with active Juvenile Idiopathic Arthritis
Sponsor: Fondazione IRCCS Ca Granda Ospedale Maggiore Policlinico (Hospital/Clinic/Other health care facility). Phase: Therapeutic use (Phase IV). Countries: Italy (ongoing, recruitment ended).
Therapeutic area(s): Diseases [C] - Musculoskeletal Diseases [C05]
Gender: Female, Male. Age: 0-17 years. Enrolment: 290.
Status: Ongoing, recruitment ended. Start date (EU): 2022-10-01. Decision date: 2024-08-19. Results received: No. Last updated: 2025-04-17.

Condition(s): Juvenile Idiopathic Arthritis
Product: Enbrel 25 mg powder and solvent for solution for injection, ADALIMUMAB, ETANERCEPT, Humira 20 mg solution for injection in pre-filled syringe

Primary endpoint: Clinical remission. Efficacy of therapeutic strategies will be compared by assessing the frequency of clinical remission (CR) at 18 months (6 months after randomization for entrance in Phase B). CR is defined as the persistence of the Juvenile Arthritis Disease Activity Score (JADAS) state of inactive disease (ID) for at least 6 months. Assessment of efficacy of the switch will be determined comparing the proportion of patients in CR at 18 months in the switched vs the non switched cohort

Source: https://euclinicaltrials.eu/ctis-public/view/2024-515557-22-00